EU clinical trial 2025-520831-18-00: A Phase 2b, Multicenter, Randomized, Double-Blind, Placebo-Controlled, Parallel-Group Study to Assess the Efficacy, Safety, and Tolerability of IMVT-1402 in Adult Participants with Primary Sjogren’s Disease with Moderate to Severe Systemic Disease Activity
Protocol code: IMVT-1402-2801
Sponsor: Immunovant Sciences GmbH (Pharmaceutical company). Phase: Therapeutic exploratory (Phase II). Countries: Germany (ongoing, recruiting), Greece (ongoing, recruiting), Romania (ongoing, recruiting), Spain (ongoing, recruiting), Poland (ongoing, recruitment ended), Italy (ongoing, recruiting), Hungary (ongoing, recruiting).
Therapeutic area(s): Diseases [C] - Immune System Diseases [C20]
Gender: Female, Male. Age: 18-64 years, 65+ years. Enrolment: 143.
Start date (EU): 2025-12-12. Decision date: 2025-11-24. Results received: No. Last updated: 2026-07-21.
Decision dates by country: HU: 2026-03-09, PL: 2025-11-30, GR: 2025-11-24, DE: 2025-11-24, ES: 2025-11-27, RO: 2025-12-02, IT: 2025-11-25

Condition(s): Primary Sjogren’s Disease
Product: IMVT-1402, Placebo is identical to IMP but with no active substance

Primary endpoint: Change from Baseline in clinESSDAI score at Week 24.

Source: https://euclinicaltrials.eu/ctis-public/view/2025-520831-18-00